EU clinical trial 2023-508998-85-00: A study to find a suitable dose of BI 765883 and to test whether it helps people with advanced pancreatic cancer when taken alone or together with chemotherapy
Protocol code: 1505-0001
Sponsor: Boehringer Ingelheim International GmbH, Boehringer Ingelheim International GmbH, Boehringer Ingelheim Espana S.A. (Pharmaceutical company). Phase: Human Pharmacology (Phase I)- First administration to humans. Countries: France (ended), Germany (ended), Spain (ended), Belgium (ended).
Therapeutic area(s): Diseases [C] - Neoplasms [C04]
Gender: Female, Male. Age: 18-64 years, 65+ years. Enrolment: 48.
Status: Ended. Start date (EU): 2025-01-28. End date (EU): 2025-05-22. End date: 2025-06-19. Decision date: 2024-08-05. Results received: No. Last updated: 2024-12-20.
Decision dates by country: FR: 2024-08-12, DE: 2024-08-09, ES: 2024-08-08, BE: 2024-08-05

Condition(s): Metastatic pancreatic ductal adenocarcinoma (mPDAC)

Source: https://euclinicaltrials.eu/ctis-public/view/2023-508998-85-00